EU clinical trial 2022-501901-10-00: A Registry Study of Treatment With Bulevirtide in Participants With Chronic Hepatitis D Infection
Protocol code: GS-US-589-6206
Sponsor: Gilead Sciences Inc. (Pharmaceutical company). Phase: Therapeutic use (Phase IV). Countries: France (ended), Austria (ended), Germany (ended), Romania (ended), Belgium (ended), Spain (ended), Netherlands (ended).
Therapeutic area(s): Diseases [C] - Virus Diseases [C02]
Gender: Female, Male. Age: 18-64 years, 65+ years. Enrolment: 220.
Status: Ended. Start date (EU): 2023-02-06. End date (EU): 2026-05-22. Decision date: 2023-01-19. Results received: No. Last updated: 2026-01-13.
Decision dates by country: AT: 2023-01-30, BE: 2023-10-04, NL: 2023-11-09, RO: 2023-09-18, ES: 2023-10-24, DE: 2023-01-19, FR: 2023-01-19

Condition(s): Chronic Hepatitis D Infection
Product: HEPCLUDEX 2 mg powder for solution for injection

Primary endpoint: Exposure-adjusted incidence of participants with liverrelated events: hepatic decompensation (ie, ascites, jaundice, hepatic encephalopathy, portal hypertensionrelated gastro-intestinal bleeding [GIB]), hepatocellular carcinoma (HCC), liver transplantation, and liver-related death through 144 weeks of BLV treatment
Endpoint(s): Percentage of participants who develop cirrhosis during the study among participants who were previously noncirrhotic Percentage of participants with serious adverse events (SAEs), Grade 3 or 4 adverse events (AEs), and discontinuations due to AEs

Source: https://euclinicaltrials.eu/ctis-public/view/2022-501901-10-00